EU clinical trial 2023-505346-26-01: First in Human Study of TOS-358 in Adults with Soid Tumors
Protocol code: TOS-358-001
Sponsor: Totus Medicines Inc. (Pharmaceutical company). Phase: Phase I and Phase II (Integrated)- First administration to humans. Countries: Spain (ongoing, recruiting).
Therapeutic area(s): Diseases [C] - Neoplasms [C04]
Gender: Female, Male. Age: 18-64 years, 65+ years. Enrolment: 175.
Status: Ongoing, recruiting. Start date (EU): 2024-02-19. Decision date: 2024-01-10. Results received: No. Last updated: 2026-04-21.

Condition(s): 9 main solid tumors – colorectal, cervical, endometrial, gastric, urothelial, breast, head and neck, ovarian and non-small cell lung cancers.

Source: https://euclinicaltrials.eu/ctis-public/view/2023-505346-26-01